EU clinical trial 2023-504447-14-00: A Multicenter, Randomized, Placebo and Active Comparator-Controlled Clinical Trial to Study the Efficacy, Safety and Pharmacokinetics (PK) of Tildrakizumab in Pediatric Subjects from 6 to <18 Years of Age with Moderate to Severe Chronic Plaque Psoriasis
Protocol code: TILD-19-12
Sponsor: Sun Pharmaceutical Industries Limited (Pharmaceutical company). Phase: Phase II and Phase III (Integrated). Countries: Hungary (ongoing, recruiting), Slovakia (ongoing, recruiting), Spain (ended), Poland (ongoing, recruiting).
Therapeutic area(s): Diseases [C] - Skin and Connective Tissue Diseases [C17]
Gender: Female, Male. Age: 0-17 years. Enrolment: 105.
Start date (EU): 2021-07-29. Decision date: 2024-06-14. Results received: No. Last updated: 2026-06-09.
Decision dates by country: ES: 2024-06-14, HU: 2024-06-17, PL: 2024-07-05, SK: 2024-06-18

Condition(s): Treatment of pediatric subjects with moderate to severe chronic plaque psoriasis
Product: Tildrakizumab, Enbrel 25 mg powder for solution for injection, Tildrakizumab matching placebo

Primary endpoint: Part A • Pharmacokinetic parameters of tildrakizumab like observed maximum plasma concentration (Cmax), time to observed maximum plasma concentration in plasma (Tmax), area under the plasma concentration-time curve (AUC), half-life (T1/2), apparent volume of distribution (Vd/F) and clearance (CL)., Part B • The proportion of subjects with at least 75% improvement in the PASI score (PASI 75 response) from baseline at Week 16. • The proportion of subjects with PGA score of “clear” or “minimal” with at least a 2-grade reduction from baseline at Week 16.
Endpoint(s): Please refer to the enclosed protocol for more details regarding secondary endpoints.

Source: https://euclinicaltrials.eu/ctis-public/view/2023-504447-14-00